EU clinical trial 2024-516540-25-00: A Phase 1/2, Open-label Study of Nivolumab Monotherapy or Nivolumab combined with Ipilimumab in Subjects with Advanced or Metastatic Solid Tumors
Protocol code: CA209-032
Sponsor: Bristol Myers Squibb International Corporation (Pharmaceutical company). Phase: Phase I and Phase II (Integrated)- Other. Countries: Germany (ended).
Therapeutic area(s): Diseases [C] - Neoplasms [C04]
Gender: Female, Male. Age: 18-64 years, 65+ years. Enrolment: 83.
Status: Ended. Start date (EU): 2013-12-11. End date (EU): 2024-11-18. End date: 2024-11-19. Decision date: 2024-09-12. Results received: Yes. Last updated: 2024-11-22.

Condition(s): Advanced or metastatic solid tumors: 1) Triple Negative Breast Cancer (TNBC); 2) Gastric Cancer (GC); 3) Pancreatic Cancer (PC); 4) Small Cell Lung Cancer (SCLC). 5) Bladder Cancer (BC); 6) Ovarian Cancer (OC)
Product: OPDIVO 10 mg/mL concentrate for solution for infusion., Ipilimumab, Ipilimumab

Primary endpoint: Objective response rate (ORR) in all assigned subjects as determined by the investigators. ORR is defined as the number of subjects with a confirmed best overall response (BOR) of complete response (CR) or partial response (PR) divided by the number of assigned subjects
Endpoint(s): Rate of treatment-related adverse events (AEs) leading to drug discontinuations during the first 12 weeks of treatment, Progression Free Survival (PFS), Overall Survival (OS)

Source: https://euclinicaltrials.eu/ctis-public/view/2024-516540-25-00